EU clinical trial 2024-516436-10-00: An international, multicenter, randomized, double-blind, phase 3 pivotal registrational clinical study of APG-2575 (Lisaftoclax) combined with azacitidine in elderly patients with newly diagnosed acute myeloid leukemia (GLORA-3)
Protocol code: APG2575AG301
Sponsor: Ascentage Pharma Group Inc. (Pharmaceutical company). Phase: Therapeutic confirmatory (Phase III). Countries: Italy (authorised, recruitment pending), Spain (ongoing, recruiting), Poland (authorised, recruitment pending).
Therapeutic area(s): Diseases [C] - Neoplasms [C04]; Diseases [C] - Hemic and Lymphatic Diseases [C15]
Gender: Female, Male. Age: 18-64 years, 65+ years. Enrolment: 58.
Start date (EU): 2026-06-18. Decision date: 2025-05-05. Results received: No. Last updated: 2026-04-24.
Decision dates by country: PL: 2025-10-26, ES: 2025-10-20, IT: 2025-05-05

Condition(s): Acute myeloid leukemia
Product: AZACITIDINE, Lisaftoclax, Dummy APG-2575 oral tablets, matching APG-2575 oral tablets. strength: 200 mg/tablet., AZACITIDINE

Primary endpoint: Overall survival (OS): Interval between the date of randomization to the date of death of any cause. Survival time will be censored at the latest known survival date of the subject if death cannot be confirmed.
Endpoint(s): Event-free survival (EFS): The interval from the date of randomization to the time point when any of the following “events” occur (whichever occurs first): • Progressive disease; • Disease recurrence after CR/CRi/CRh/MLFS; • Death of any cause (including but not limited to death caused by leukemia or therapeutic drugs); • CR/CRi/CRh/MLFS is not achieved after at least 6 treatment cycles., Complete response (CR) rate: The proportion of patients with complete response in the total analysis population., Overall response rate (ORR): The proportion of patients who have achieved CR, CRi, CRh, MLFS and PR in total analysis population., Composite complete response (CRc) rate: The proportion of patients who have achieved CR, CRi and CRh in total analysis population., Time to response (TTR): The interval from the date of randomization to the date of the first CR, CRi, or CRh., Duration of response (DOR): The interval from the date of confirming response (CR/CRi/CRh) to the date of disease recurrence or death of any cause (whichever occurs first). DOR will be calculated for patients with the best response of CR, CRh and CRi separately., Safety and tolerability of subjects: Treatment emergent adverse events (TEAEs) and treatment related adverse events (TRAEs) will be evaluated., Population pharmacokinetic (Pop PK) parameters of APG-2575., Results of EORTC QLQ C30 (V3) and EuroQol 5-Dimension (EQ-5D) questionnaire.

Source: https://euclinicaltrials.eu/ctis-public/view/2024-516436-10-00